EU clinical trial 2024-512415-45-00: IKS03 in Advanced B cell NHL
Protocol code: IKS03-01
Sponsor: Iksuda Therapeutics Limited (Pharmaceutical company). Phase: Human Pharmacology (Phase I)- Other. Countries: Spain (ongoing, recruiting), Italy (ongoing, recruiting).
Therapeutic area(s): Diseases [C] - Neoplasms [C04]
Gender: Female, Male. Age: 18-64 years, 65+ years. Enrolment: 80.
Status: Ongoing, recruiting. Start date (EU): 2025-01-14. Decision date: 2024-09-13. Results received: No. Last updated: 2026-07-01.
Decision dates by country: ES: 2024-09-16, IT: 2024-09-13

Condition(s): Advanced B cell Non-Hodgkin Lymphomas

Source: https://euclinicaltrials.eu/ctis-public/view/2024-512415-45-00